EU clinical trial 2024-518364-12-00: An Open-Label Extension Study to Assess Long-term Safety and Tolerability of Batoclimab in Adult Participants with Chronic Inflammatory Demyelinating Polyneuropathy (CIDP)
Protocol code: IMVT-1401-2402
Sponsor: Immunovant Sciences GmbH (Pharmaceutical company). Phase: Therapeutic exploratory (Phase II). Countries: Belgium (ended), Denmark (ended), Italy (ended), Romania (ended), Germany (ended), Slovakia (ended), Norway (ended), Bulgaria (ended), Greece (ended), Poland (ended).
Therapeutic area(s): Diseases [C] - Nervous System Diseases [C10]
Gender: Female, Male. Age: 18-64 years, 65+ years. Enrolment: 35.
Status: Ended. Start date (EU): 2025-05-09. End date (EU): 2026-04-17. End date: 2026-04-18. Decision date: 2025-04-01. Results received: No. Last updated: 2025-08-20.
Decision dates by country: BG: 2025-04-07, DK: 2025-04-01, NO: 2025-04-01, SK: 2025-04-03, PL: 2025-04-06, RO: 2025-04-07, BE: 2025-04-01, IT: 2025-04-03, GR: 2025-04-01, DE: 2025-04-02

Condition(s): Chronic Inflammatory Demyelinating Polyneuropathy (CIDP)
Product: Batoclimab

Primary endpoint: Proportion of participants with TEAEs, SAEs, and TEAEs leading to study treatment discontinuation.
Endpoint(s): Change from baseline over time in the following scores: • Adjusted INCAT • Mean Grip Strength

Source: https://euclinicaltrials.eu/ctis-public/view/2024-518364-12-00